EU clinical trial 2023-506891-28-00: A Phase III, Randomised, Double blind, Placebo controlled, Multicentre, International Study of Durvalumab plus Domvanalimab (AB154) in Participants with Locally Advanced (Stage III), Unresectable Non small Cell Lung Cancer Whose Disease has not Progressed Following Definitive Platinum based Concurrent Chemoradiation Therapy (PACIFIC-8)
Protocol code: D9075C00001
Sponsor: Astrazeneca AB (Pharmaceutical company). Phase: Therapeutic confirmatory (Phase III). Countries: Belgium (ongoing, recruitment ended), Romania (ongoing, recruitment ended), Germany (ongoing, recruitment ended), Poland (ongoing, recruitment ended), Hungary (ongoing, recruitment ended), Italy (ongoing, recruitment ended), France (ongoing, recruitment ended), Spain (ongoing, recruitment ended), Norway (ongoing, recruitment ended), Greece (ongoing, recruitment ended).
Therapeutic area(s): Diseases [C] - Neoplasms [C04]
Gender: Female, Male. Age: 18-64 years, 65+ years. Enrolment: 280.
Status: Ongoing, recruitment ended. Start date (EU): 2022-05-02. Decision date: 2024-01-31. Results received: No. Last updated: 2026-08-04.
Decision dates by country: FR: 2024-01-31, GR: 2024-06-17, PL: 2024-02-20, BE: 2024-02-02, RO: 2024-02-05, DE: 2024-02-02, HU: 2024-02-02, IT: 2024-02-07, ES: 2024-01-31, NO: 2024-02-02

Condition(s): The target population of interest in this study is participants with locally advanced (Stage III), unresectable NSCLC, whose tumours express PD L1 TC ≥ 1% as assessed by a central reference laboratory using the VENTANA PD-L1 (SP263) IHC assay, and who did not progress after definitive platinum based cCRT.
Product: INFLIXIMAB, DOMVANALIMAB, PLACEBO, IMFINZI 50 mg/mL concentrate for solution for infusion., MYCOPHENOLATE MOFETIL

Primary endpoint: Progression Free Survival (PFS) using Blinded Independent Central Review (BICR) assessment according to RECIST 1.1 with participants with PD-L1 TC>=50%. PFS will be evaluated every 00 weeks (±00 days) from randomisation through 00 weeks, and q00w (± 00 days) thereafter until RECIST 1.1 defined radiological progression, plus 1 or more follow-up scans.
Endpoint(s): PFS in PD-L1 TC ≥ 1% by BICR. Comparison of durvalumab + domvanalimab to durvalumab + placebo in TC ≥ 1% or TC ≥ 50% in: 1. Overall Survival (OS) 2. PFS by investigator 3. PFS6, PFS12, PFS18, PFS24 4. OS at 24 months 5. ORR and DoR by BICR 6. PFS2, TTDM, TFST 7. PK and immunogenicity of durvalumab and domvanalimab 8. Time to First Confirmed Deterioration (TTFCD) in pulmonary symptoms measured by the NSCLC-SAQ.

Source: https://euclinicaltrials.eu/ctis-public/view/2023-506891-28-00